EU clinical trial 2023-508364-29-00: A Phase 3, Randomized, Double-blind, Placebo-controlled Multicenter Study to Evaluate the Efficacy and Safety of Patisiran in Patients with Transthyretin Amyloidosis with Cardiomyopathy (ATTR Amyloidosis with Cardiomyopathy)
Protocol code: ALN-TTR02-011
Sponsor: Alnylam Pharmaceuticals Inc. (Pharmaceutical company). Phase: Therapeutic confirmatory (Phase III). Countries: Denmark (ended), Belgium (ended), Italy (ended), Sweden (ended), Czechia (ended), Netherlands (ended), France (ended), Portugal (ended).
Therapeutic area(s): Diseases [C] - Cardiovascular Diseases [C14]
Gender: Female, Male. Age: 18-64 years, 65+ years. Enrolment: 79.
Status: Ended. Start date (EU): 2019-11-22. End date (EU): 2025-05-15. End date: 2025-12-24. Decision date: 2024-11-25. Results received: No. Last updated: 2025-08-14.
Decision dates by country: CZ: 2024-11-27, IT: 2024-12-02, PT: 2024-11-26, SE: 2024-11-25, NL: 2024-11-28, DK: 2024-11-26, BE: 2024-11-26, FR: 2024-11-25

Condition(s): Transthyretin Amyloidosis with Cardiomyopathy (ATTR Amyloidosis with Cardiomyopathy)
Product: Onpattro 2 mg/mL concentrate for solution for infusion., Sodium Chloride Intravenous Infusion BP 0.9% w/v

Primary endpoint: Change from baseline at Month 12 in 6-MWT
Endpoint(s): 1. Change from baseline at Month 12 in Kansas City Cardiomyopathy Questionnaire Overall Summary (KCCQ-OS) score, 2. Composite endpoint of all-cause mortality, frequency of cardiovascular (CV) events (CV hospitalizations and urgent HF visits) and change from baseline in 6-MWT over the 12-month double-blind period, 3. Composite endpoint of all-cause mortality and frequency of all-cause hospitalizations and urgent HF visits over the 12-month double-blind period A135

Source: https://euclinicaltrials.eu/ctis-public/view/2023-508364-29-00